EU clinical trial 2024-518947-40-01: Benefits on Post-operative Pain of Intravenous, Intraoperative, Tranexamic Acid Injection During Arthroscopic Shoulder Surgery.
Protocol code: ASCOT
Sponsor: Aquitaine Sante (Hospital/Clinic/Other health care facility). Phase: Therapeutic confirmatory (Phase III). Countries: France (ended).
Therapeutic area(s): Analytical,Diagnostic,Therapeutic Techniques and Equipment [E]-Surgical Procedures, Operative [E04]; Analytical, Diagnostic and Therapeutic Techniques and Equipment [E] - Anesthesia and Analgesia [E03]
Gender: Female, Male. Age: 18-64 years, 65+ years. Enrolment: 220.
Status: Ended. Start date (EU): 2025-01-07. End date (EU): 2025-07-25. Decision date: 2025-01-07. Results received: No. Last updated: 2025-03-04.

Condition(s): Patient requiring shoulder arthroscopy
Product: EXACYL 0,5 g/5 ml I.V., solution injectable, CHLORURE DE SODIUM 0,9 % BAXTER, solution pour perfusion en poche

Primary endpoint: Evaluation of the use of morphine treatments in the 24 postoperative hours (yes/no).
Endpoint(s): Shoulder pain is assessed through a Visual Analog Scale (0-100) performed 24 hours post-operative and 7 days after surgery (online assessment with the help of software), Satisfaction will be assessed through an Evaluation of the Experience of General Anesthesia questionnaire., The functionality of the shoulder will be evaluated at 30 days by the Subjective Shoulder Value scale and and Constant Score., Collection of adverse events throughout the duration of the study.

Source: https://euclinicaltrials.eu/ctis-public/view/2024-518947-40-01